EU clinical trial 2024-512603-39-00: A Phase I/IIb extension study assessing the long-term safety and efficacy of an adeno-associated viral vector containing a codon-optimized human factor IX gene (AAV5-hFIX) previously administered to adult patients with severe or moderately severe haemophilia B during the CT-AMT-060-01 Phase I/II study.
Protocol code: CSL220_1002
Sponsor: CSL Behring LLC (Pharmaceutical company). Phase: Phase I and Phase II (Integrated)- First administration to humans. Countries: Netherlands (ended), Germany (ended).
Therapeutic area(s): Diseases [C] - Hemic and Lymphatic Diseases [C15]
Gender: Male. Age: 18-64 years, 65+ years. Enrolment: 9.
Status: Ended. Start date (EU): 2021-01-08. End date (EU): 2026-03-26. End date: 2026-03-27. Decision date: 2024-06-12. Results received: No. Last updated: 2025-05-22.
Decision dates by country: NL: 2024-06-12, DE: 2024-06-17

Condition(s): Haemophilia B
Product: Hemgenix 1 x 10^13 genome copies/mL concentrate for solution for infusion

Primary endpoint: The primary endpoint is to demonstrate the long-term safety (6-10 years) after dosing of CSL220., Primary safety endpoints include the following: - AEs possibly or probably related to previous CSL220 administration, Neutralising FIX antibodies (FIX inhibitors), ALT/aspartate aminotransferase (AST) levels, Liver pathology (assessed by ultrasound), Alpha-fetoprotein (AFP)
Endpoint(s): The secondary endpoints will focus on the long-term efficacy (6-10 years) after dosing of CSL220 on FIX activity, overall FIX utilisation, bleeding events, any procedures, and QoL., Secondary efficacy endpoints include the following: - Endogenous FIX activity, Utilisation of FIX-replacement therapy, Annualized bleeding rate; including the following: o All bleeds (treated and untreated) o Spontaneous bleeds o Traumatic bleeds o Joint bleeds, Procedures (including major and minor surgeries), 36-Item Short Form Survey (SF-36) and EQ-5D-5L Quality of Life (QoL) scores, Hemophilia Joint Health Score (HJHS)

Source: https://euclinicaltrials.eu/ctis-public/view/2024-512603-39-00